EU clinical trial 2024-519743-15-00: Randomized, Observer-Blind, Active-Controlled, Phase III Study in Adults ≥ 60 years of Age to Assess the Safety and Immunogenicity of Abbott’s Candidate High-Dose Influenza Vaccine.
Protocol code: INFQ-324-0476
Sponsor: Abbott Biologicals B.V. (Pharmaceutical company). Phase: Therapeutic confirmatory (Phase III). Countries: Spain (ongoing, recruitment ended), Bulgaria (ongoing, recruitment ended), Estonia (ongoing, recruitment ended), Finland (ongoing, recruitment ended), Belgium (ongoing, recruitment ended).
Therapeutic area(s): Diseases [C] - Virus Diseases [C02]
Gender: Female, Male. Age: 18-64 years, 65+ years. Enrolment: 1193.
Status: Ongoing, recruitment ended. Start date (EU): 2025-10-20. Decision date: 2025-06-17. Results received: No. Last updated: 2026-08-06.
Decision dates by country: BG: 2025-06-19, EE: 2025-06-25, BE: 2025-07-18, FI: 2025-06-27, ES: 2025-06-23

Condition(s): Influenza immunisation
Product: Influvac, suspensie voor injectie 0,5 ml (influenza vaccin, oppervlakte antigeen, geïnactiveerd)., Efluelda Injektionssuspension in einer Fertigspritze Trivalenter Influenza-Spaltimpfstoff (inaktiviert), 60 Mikrogramm HA/Stamm, Trivalent Influenza Vaccine - High Dose (TIV-HD)

Primary endpoint: Postvaccination HI GMTs for each of the three strains 28 days (Day 29) after the first vaccination.
Endpoint(s): 1. Postvaccination HI GMTs for each of the three strains after the revaccination., 2. Postvaccination VN GMTs for each of the three strains after the first and the revaccination., 3. Postvaccination HI and VN geometric mean fold increases (GMFIs) and seroconversion rates after the first and the revaccination., 4. Postvaccination reverse cumulative distribution (RCD) curves for HI and VN titers for each of the three strains after the first and the revaccination., 5. Postvaccination CMI values., 6. Unsolicited (i.e., spontaneously reported) AEs within 28 days following each vaccination, including SAEs, AESIs, MAEs, and NCIs., 7. Serious adverse events, AESIs, MAEs, and NCIs from Day 29 to Month 6 postvaccination (first vaccination only)., 8. Solicited (i.e., prelisted in subject eDiary) injection site adverse reactions and systemic adverse reactions within 7 days following each vaccination. The following adverse reactions will be assessed (injection site): erythema, swelling, induration, pain, and ecchymosis, and (systemic): fever, headache, fatigue, malaise, myalgia, arthralgia, sweating, and shivering.

Source: https://euclinicaltrials.eu/ctis-public/view/2024-519743-15-00